EU clinical trial 2023-503661-28-00: A Phase 3 Randomized, Placebo-Controlled, Double-Blind Study to Evaluate Efficacy and Safety of Upadacitinib in Adult and Adolescent Subjects with Moderate to Severe Hidradenitis Suppurativa Who Have Failed Anti-TNF Therapy
Protocol code: M23-698
Sponsor: Abbvie Deutschland GmbH & Co. KG (Pharmaceutical company). Phase: Therapeutic confirmatory (Phase III). Countries: Slovakia (ongoing, recruitment ended), Italy (ongoing, recruitment ended), Hungary (ongoing, recruitment ended), Portugal (ongoing, recruitment ended), Germany (ongoing, recruitment ended), Finland (ongoing, recruitment ended), Spain (ongoing, recruitment ended), Greece (ongoing, recruitment ended), Czechia (ongoing, recruitment ended), France (ongoing, recruitment ended), Bulgaria (ongoing, recruitment ended), Austria (ongoing, recruitment ended), Sweden (ongoing, recruitment ended), Ireland (ongoing, recruitment ended), Croatia (ongoing, recruitment ended), Netherlands (ongoing, recruitment ended), Belgium (ongoing, recruitment ended), Lithuania (ongoing, recruitment ended).
Therapeutic area(s): Diseases [C] - Immune System Diseases [C20]; Diseases [C] - Skin and Connective Tissue Diseases [C17]
Gender: Female, Male. Age: 0-17 years, 18-64 years, 65+ years. Enrolment: 542.
Status: Ongoing, recruitment ended. Start date (EU): 2023-10-26. Decision date: 2023-10-03. Results received: No. Last updated: 2026-07-08.
Decision dates by country: DE: 2023-10-04, ES: 2023-10-04, LT: 2023-10-06, PT: 2023-10-03, BG: 2023-10-09, NL: 2023-10-09, FR: 2023-10-11, BE: 2023-10-09, GR: 2023-10-03, SE: 2024-02-22, SK: 2023-10-04, IE: 2023-10-06, HU: 2023-10-04, AT: 2023-10-09, CZ: 2023-10-05, HR: 2023-10-09, FI: 2023-10-04, IT: 2023-10-05

Condition(s): Hidradenitis Suppurativa
Product: Matching Placebo for Upadacitinib, Upadacitinib, Upadacitinib

Primary endpoint: The primary endpoint is the achievement of HiSCR 50 at Week 16. HiSCR 50 is defined as at least a 50% reduction in the total abscess and inflammatory nodule (AN) count with no increase in abscess count and no increase in draining fistula count relative to Baseline.
Endpoint(s): Change from Baseline in draining fistula count at Week 16;", Achievement of HiSCR 75 (at least a 75% reduction in the total AN count with no increase in abscess count and no increase in draining fistula count relative to Baseline) at Week 16, Achievement of NRS30 (at least a 30% reduction and at least 2 units reduction from Baseline in the Patient's Global Assessment of HS-related skin pain NRS) at Week 4 among subjects with NRS ≥ 3 at Baseline. The NRS30 is based on worst skin pain in a 24-hour recall period (maximal daily pain);, Change from Baseline in Hidradenitis Suppurativa Symptom Assessment (HSSA) at Week 16, Change from Baseline in Hidradenitis Suppurativa Impact Assessment (HSIA) at Week 16, Change from Baseline in Dermatology Life Quality Index (DLQI) for adult subjects and adolescent subjects age ≥ 16 years old at Week 16", Change from Baseline in HS-related odor, based on HSSA Question 8, at Week 16., Change from Baseline in the Patient's Global Assessment of HS-related skin pain NRS at Week 8, Occurrence of HS flare, defined as at least one occurrence of a ≥ 25% increase in AN count, with a minimum absolute increase of 2 relative to Baseline, during Period 1. "

Source: https://euclinicaltrials.eu/ctis-public/view/2023-503661-28-00